EU clinical trial 2022-500290-14-01: A randomized, double-blind, placebo controlled, dose-finding study to assess the efficacy and safety of SAR443122 in adult patients with moderate to severe ulcerative colitis
Protocol code: DRI16804
Sponsor: Sanofi-Aventis Research & Development (Pharmaceutical company). Phase: Therapeutic exploratory (Phase II). Countries: Czechia (ended), France (ongoing, recruitment ended), Spain (ended), Germany (ended), Hungary (ongoing, recruitment ended), Netherlands (ended), Poland (ongoing, recruitment ended), Italy (ongoing, recruitment ended), Slovakia (ended), Bulgaria (ongoing, recruitment ended), Romania (ongoing, recruitment ended).
Therapeutic area(s): Diseases [C] - Digestive System Diseases [C06]
Gender: Female, Male. Age: 18-64 years, 65+ years. Enrolment: 129.
Start date (EU): 2023-05-11. Decision date: 2023-04-17. Results received: No. Last updated: 2025-11-06.
Decision dates by country: HU: 2023-04-18, NL: 2023-04-19, DE: 2023-04-18, CZ: 2023-04-19, ES: 2023-04-17, BG: 2025-05-22, RO: 2025-05-26, IT: 2023-04-18, PL: 2023-04-19, SK: 2024-05-13, FR: 2023-04-17

Condition(s): Colitis ulcerative
Product: Matched Placebo for Test

Primary endpoint: Proportion of participants who achieve clinical remission at Week 12 by modified Mayo Score (mMS). The Mayo score (full MS) is a composite instrument that consists of patient reported stool frequency and rectal bleeding, endoscopy-derived measures and physician-reported assessment (PGA). The modified Mayo score is calculated omitting PGA. And an endoscopy score of 1 with no friability.
Endpoint(s): Proportion of participants who achieve endoscopic improvement at Week 12, Proportion of participants who achieve clinical response at Week 12 by mMS, Proportion of participants who achieve clinical remission at Week 12 by full Mayo Score (MS), Proportion of participants who achieve clinical response at Week 12 by MS., Change from baseline on patient-reported outcome 2 (PRO2) total score (Mayo stool frequency and rectal bleeding subscores) over time, Proportion of participants who achieve histological improvement at Week 12, Proportion of participants who achieve Histologic-endoscopic mucosal improvement (HEMI) at Week 12 defined by achievement of modified Mayo endoscopic improvement and histological improvement, Change from baseline in Inflammatory Bowel Disease Questionnaire (IBDQ) total score at Week 12, Change from baseline in bowel signs and symptoms assessed by Ulcerative Colitis Patient Reported Outcome Signs and Symptoms (UC-PRO/SS) at Week 12, Change from baseline in abdominal signs and symptoms assessed by UC-PRO/SS at Week 12, Pharmacokinetic parameters: maximum concentration [Cmax], Pharmacokinetic parameters: time to Cmax [tmax], Pharmacokinetic parameters: area under the curve over the dosing interval [AUC0-tau], Pharmacokinetic parameters: elimination half-life [t1/2z], Participants with any Treatment Emergent Adverse Events (TEAEs) during induction and maintenance treatment period, Participants with any TEAEs during open-label treatment period

Source: https://euclinicaltrials.eu/ctis-public/view/2022-500290-14-01